EU clinical trial 2024-511336-28-00: A Prospective Phase I/II, Single-Arm, Open-Label, Multicentre Study to Evaluate the Safety and Efficacy of Tafasitamab (MOR00208) in Pediatric Patients with Relapsed or Refractory Acute B Lineage Leukemia
Sponsor: Universitaetsklinikum Tuebingen AöR (Hospital/Clinic/Other health care facility). Phase: Phase I and Phase II (Integrated)- Other. Countries: Germany (ongoing, recruiting).
Therapeutic area(s): Diseases [C] - Neoplasms [C04]
Gender: Female, Male. Age: 0-17 years. Enrolment: 20.
Status: Ongoing, recruiting. Start date (EU): 2023-08-11. Decision date: 2024-08-15. Results received: No. Last updated: 2026-01-30.

Condition(s): Leukemia in childhood
Product: MINJUVI 200 mg powder for concentrate for solution for infusion

Primary endpoint: Time until hematological relapse (> 5% leukemic blasts) or increase of MRD ≥ 2 log in bone marrow during an observation time of 545 days accounting for competing risks.
Endpoint(s): Rate of patients with treatment success defined as survival without newly emerging MRD or increasing MRD ≥ 2 log in bone marrow or peripheral blood or unacceptable toxicity., Overall survival., Rate of patients with MRD reduction of at least 1 log at any time point compared to basline MRD measurement between SCT and start of study treatment. - B cell numbers, Cytotoxicity of patient derived PBMCs against cell lines (NALM) and cryopreserved autologous blasts at several time points., Pharmacokinetic of MOR00208., Safety endpoint: Any toxicity irrespective of grade, Safety endpoint: Number of Deaths, Safety endpoint: Number of relapses, Safety endpoint: Adverse events will be presented in line listings and also in cumulative tabulations.

Source: https://euclinicaltrials.eu/ctis-public/view/2024-511336-28-00